EU clinical trial 2024-515025-28-00: A Phase 3, Multicenter, Randomized, Double-blind, Placebo-Controlled Study to Evaluate the Efficacy and Safety of Mitapivat in Pediatric Subjects With Pyruvate Kinase Deficiency Who Are Not Regularly Transfused, Followed by a 5-Year Open-label Extension Period
Protocol code: AG348-C-023
Sponsor: Agios Pharmaceuticals Inc. (Pharmaceutical company). Phase: Therapeutic confirmatory (Phase III). Countries: France (ongoing, recruitment ended), Italy (ended), Germany (ongoing, recruitment ended), Spain (ongoing, recruitment ended), Netherlands (ended).
Therapeutic area(s): Diseases [C] - Hemic and Lymphatic Diseases [C15]
Gender: Female, Male. Age: 0-17 years. Enrolment: 14.
Start date (EU): 2022-05-24. Decision date: 2024-07-09. Results received: No. Last updated: 2025-11-26.
Decision dates by country: IT: 2024-08-28, NL: 2024-07-09, FR: 2024-07-16, DE: 2024-07-29, ES: 2024-07-16

Condition(s): Pyruvate Kinase Deficiency
Product: MITAPIVAT, MITAPIVAT, Placebo for AG-348, MITAPIVAT, MITAPIVAT

Primary endpoint: Hb response, defined as a ≥1.5 g/dL (0.93 mmol/L) increase in Hb concentration from baseline that is sustained at 2 or more scheduled assessments at Weeks 12, 16, and 20 during the Double-blind Period. The individual subject’s baseline Hb concentration is defined as the average of all available Hb concentrations collected for that subject during the Screening Period up to the first dose of study drug

Source: https://euclinicaltrials.eu/ctis-public/view/2024-515025-28-00